EU clinical trial 2024-511185-37-00: A Randomized Prospective Trial of Adjuvant Chemotherapy in Patients with Completely Resected Stage I or IIA Non-Squamous Non-Small Cell Lung Cancer Identified as High or Intermediate Risk by a 14-Gene Prognostic Assay
Protocol code: EC-120888
Sponsor: Razor Genomics Inc., Intergroupe Francophone De Cancerologie Thoracique (Laboratory/Research/Testing facility, Patient organisation/association). Phase: Therapeutic use (Phase IV). Countries: Germany (ongoing, recruitment ended), France (ongoing, recruitment ended).
Therapeutic area(s): Diseases [C] - Neoplasms [C04]
Gender: Female, Male. Age: 18-64 years, 65+ years. Enrolment: 300.
Status: Ongoing, recruitment ended. Start date (EU): 2020-11-03. Decision date: 2024-03-27. Results received: No. Last updated: 2025-11-21.
Decision dates by country: FR: 2024-03-27, DE: 2024-03-28

Condition(s): Completely resected stage I or IIA non-squamous non-small cell lung cancer (NSCLC)
Product: CARBOPLATIN, PACLITAXEL, DOCETAXEL, VINORELBINE TARTRATE, CISPLATIN, PEMETREXED

Primary endpoint: The primary efficacy analysis is based on the duration of DFS in patients determined to be at High- and Intermediate Risk by the 14-Gene Prognostic Assay. DFS is defined as the time from randomization to disease recurrence, or death from any cause. Patients without events at the time of analysis will be censored at their last known event-free date. The primary efficacy analysis will be based on the modified intent-to-treat (mITT) population.
Endpoint(s): The key secondary efficacy analysis is based on the duration of DFS in patients in the standard intent-to-treat (ITT) population. Patients without events at the time of analysis will be censored at their last known event-free date. An additional key secondary efficacy analysis is based on the duration of DFS in the per-protocol (PP) population., Additional Secondary analysis: OS in patients determined to be at High or Intermediate Risk by the 14-Gene Prognostic Assay is defined to be the time from randomization to death. Patients alive at the end of the analysis will be censored at their last known alive date., Time to recurrence (TTR) in patients determined to be at High or Intermediate Risk by the 14-Gene Prognostic Assay is defined as length of time from randomization until documented disease recurrence, with death as a competing risk. For TTR, recurrences that are first diagnosed at time of death will be treated as recurrences at date of death. Patients without documented recurrence will be censored at their last documented FU. These analyses will be undertaken for mITT, ITT and PP populations., An additional secondary endpoint of the trial is to compare OS and, to the degree possible, DFS and TTR in patients identified by the 14-Gene Prognostic Assay as High or Intermediate risk stage I or IIA non-squamous NSCLC randomized to observation with patients identified by the 14-Gene Prognostic Assay as Low-Risk stage I or IIA non-squamous NSCLC.

Source: https://euclinicaltrials.eu/ctis-public/view/2024-511185-37-00